EU clinical trial 2023-510242-24-00: A Randomized, Placebo-controlled, Multicenter, Study to Evaluate the Impact of Upadacitinib on Spondyloarthritis Outcomes in Patients with Active Psoriatic Arthritis (UP-SPOUT)
Protocol code: B24-033
Sponsor: Care Arthritis Ltd. (Educational Institution). Phase: Therapeutic use (Phase IV). Countries: Belgium (authorised, recruiting), Poland (ongoing, recruiting).
Therapeutic area(s): Diseases [C] - Skin and Connective Tissue Diseases [C17]; Diseases [C] - Musculoskeletal Diseases [C05]
Gender: Female, Male. Age: 18-64 years, 65+ years. Enrolment: 58.
Start date (EU): 2025-12-01. Decision date: 2025-06-06. Results received: No. Last updated: 2026-07-24.
Decision dates by country: BE: 2025-06-06, PL: 2025-06-23

Condition(s): Axial Spondyloarthritis, Psoriatic Arthritis
Product: Upadacitinib, Matching placebo (no active ingredients).

Primary endpoint: Change from baseline in the Total Spondyloarthritis Research Consortium of Canada (SPARCC) MRI inflammation score (for SIJ and spine) (combination of the 23-DVU SPARCC spine (range 0-414) and the SPARCC SIJ (range 0-72)) at 12 weeks of therapy with upadacitinib vs placebo in the DMARD-IR (conventional and/or biologic) subgroup
Endpoint(s): Change from baseline in Ankylosing Spondylitis Disease Activity Score (ASDAS-CRP) at Week 12 with upadacitinib vs placebo in the DMARD-IR (conventional and/or biologic) subgroup, Change from Baseline in BASDAI at Week 12 with upadacitinib vs placebo in the DMARD-IR (conventional and/or biologic) subgroup, Change from baseline in the Total Spondyloarthritis Research Consortium of Canada (SPARCC) MRI inflammation score (for SIJ and spine) (combination of the 23-DVU SPARCC spine (range 0-414) and the SPARCC SIJ (range 0-72)) at 12 weeks of therapy with upadacitinib vs placebo in the overall population (NSAID-IR, c-DMARD-IR and and bio-DMARD-IR), Change from baseline in Ankylosing Spondylitis Disease Activity Score (ASDAS-CRP) at Week 12 with upadacitinib vs placebo in the overall population (NSAID-IR, c-DMARD-IR and and bio-DMARD-IR), Change from Baseline in BASDAI at Week 12 with upadacitinib vs placebo in the overall population (NSAID-IR, c-DMARD-IR and and bio-DMARD-IR), Incidence of Adverse Events (AEs), AEs leading to withdrawal from study drug, and serious AEs (SAEs).

Source: https://euclinicaltrials.eu/ctis-public/view/2023-510242-24-00